EU clinical trial 2024-510895-18-00: (ASK-HD-01-CS-101) An Open-Label Phase I/II Dose Finding Study to Evaluate the Safety, Tolerability, and Preliminary Efficacy of Striatal Administration of AB-1001 in Adult Subjects with Early Manifest Huntington’s Disease (HD)
Protocol code: ASK-HD-01-CS-101
Sponsor: AskBio France (Pharmaceutical company). Phase: Phase I and Phase II (Integrated)- First administration to humans. Countries: France (ongoing, recruitment ended).
Therapeutic area(s): Diseases [C] - Nervous System Diseases [C10]
Gender: Female, Male. Age: 18-64 years, 65+ years. Enrolment: 18.
Status: Ongoing, recruitment ended. Start date (EU): 2024-11-07. Decision date: 2024-03-22. Results received: No. Last updated: 2026-05-07.

Condition(s): Huntington's disease
Product: METHYLPREDNISOLONE HEMISUCCINATE, FLUDEOXYGLUCOSE (18F), GADOTERIC ACID, AB-1001

Primary endpoint: Incidence of Dose Limiting Toxicities (DLTs), Treatment Emergent Adverse Events (TEAEs), and Serious Adverse Events (SAEs) through Week 52
Endpoint(s): Magnitude and variability of change from baseline in anatomical and volumetric measures of brain regions impacted by HD (caudate, putamen, whole brain volume, grey matter volume, white matter volume, ventricular volume) as assessed by MRI at Week 52, Change from baseline in the Unified Huntington’s Disease Rating Scale composite score [cUHDRS: Total Motor Score (TMS), Total Functional Capacity (TFC), Symbol Digit Modalities Test (SDMT) and Stroop Word Reading (SWRT)] at Week 52, Change from baseline in blood and cerebrospinal fluid (CSF) mHTT, Neurofilament light chain (NfL), and 24-OH cholesterol at Week 52, Change from baseline in Magnetic Resonance Spectroscopy (MRS) metabolic profile (measuring lactate, N-acetyl aspartate, creatine, choline, glutamate, glutamine, glutathione, taurine, and myo-inositol) at Week 52, Change from baseline in Positron Emission Tomography (PET) Fluoro-deoxyglucose (FDG) striatal profile at Week 52

Source: https://euclinicaltrials.eu/ctis-public/view/2024-510895-18-00